EU clinical trial 2024-511239-91-00: A Phase I-II, Multicenter Study Evaluating the Efficacy and Safety of Multiple Therapies in Cohorts of Patients with Resectable Stage I-III Non-Small Cell Lung Cancer, selected according to Biomarker Status
Protocol code: BO43249
Sponsor: F. Hoffmann-La Roche AG (Pharmaceutical company). Phase: Therapeutic exploratory (Phase II). Countries: France (ended), Netherlands (ended), Belgium (ended), Denmark (ended), Italy (ended), Austria (ended), Poland (ended), Spain (ended).
Therapeutic area(s): Diseases [C] - Neoplasms [C04]
Gender: Female, Male. Age: 18-64 years, 65+ years. Enrolment: 54.
Status: Ended. Start date (EU): 2025-05-05. End date (EU): 2026-07-31. Decision date: 2025-03-03. Results received: No. Last updated: 2026-04-30.
Decision dates by country: AT: 2025-03-10, BE: 2025-03-03, DK: 2025-03-04, ES: 2025-03-05, NL: 2025-03-07, PL: 2025-07-28, FR: 2025-03-07, IT: 2025-03-06

Condition(s): Resectable Stage I-III Non-Small Cell Lung Cancer (NSCLC)
Product: Carboplatin Kabi 10 mg/ml Konzentrat zur Herstellung einer Infusionslösung, Cisplatin Hikma 1 mg/ml Konzentrat zur Herstellung einer Infusionslösung, CARBO-cell® 10 mg/ml Infusionslösung, Konzentrat zur Herstellung einer Infusionslösung, Alectinib (Alecensa), Pemetrexed Fresenius Kabi 25 mg/ml concentrate for solution for infusion, Cisplatin NeoCorp 1 mg/ml - Konzentrat zur Herstellung einer Infusionslösung, Pemetrexed Accord 25 mg/ml concentrate for solution for infusion, Pemetrexed Pfizer 25 mg/ml concentrate for solution for infusion., Alecensa 150 mg hard capsules, CARBOPLATINE ACCORD 10 mg/ml, solution pour perfusion, PEMETREXED, Cisplatin Teva® 1 mg/ml Konzentrat zur Herstellung einer Infusionslösung, Carboplatin Bendalis 10mg/ml, Konzentrat zur Herstellung einer Infusionslösung, CISPLATINE ACCORD 1 mg/ml, solution à diluer pour perfusion

Primary endpoint: 1. Cohort B1: Incidence, type, and severity of adverse events with onset up to 28 days after the last dose of chemotherapy treatment according to NCI CTCAE v5.0., 2. Cohort B2: Investigator-assessed pathologic complete response (inv-pCR)
Endpoint(s): 1. Cohort B1:Incidence, type, and severity of adverse events according to National Cancer Institute Common Terminology Criteria for Adverse Events, Version 5 (NCI CTCAE v5.0). Adverse Events with onset up to 28 days after the last dose of study treatment, or until last on site/discontinuation visit, whichever comes first, 2. Cohort B2:Investigator-assessed major pathological response (inv-MPR), 3. Cohort B2: Pathologic complete response (pCR) by independent review, 4. Cohort B2: Major pathologic response (MPR) by independent review, 5. Cohort B2: Investigator-assessed overall response rate (ORR) per RECIST v1.1, 6. Cohort B2: Investigator-assessed event-free survival (EFS), 7. Cohort B2: OS, 8. Cohort B2: Incidence, severity and type of AEs, with severity determined through use of NCI CTCAE v5.0, 9. Cohort B2: Change from baseline in target safety parameters (vital signs, clinical laboratory test results, ECG parameters), 10. Cohort B2: Frequency of surgery completion, defined as patients who have successfully completed surgery without treatment related delays (> 60 days) from the last dose of neoadjuvant treatment, 11. Cohort B2: Length of treatment related surgical delays, incidence of operative and post-operative complications, and/or reasons for surgical cancellations

Source: https://euclinicaltrials.eu/ctis-public/view/2024-511239-91-00